EU clinical trial 2023-506282-66-00: "ECLECTIC": EstroTEP and circulating biomarkers to determine the optimal second line therapy for ER-positive HER2-negative metastatic breast cancer patients
Protocol code: IC 2022-12
Sponsor: Institut Curie (Hospital/Clinic/Other health care facility). Phase: Therapeutic confirmatory (Phase III). Countries: France (ongoing, recruiting).
Therapeutic area(s): Diseases [C] - Neoplasms [C04]
Gender: Female. Age: 18-64 years, 65+ years. Enrolment: 300.
Status: Ongoing, recruiting. Start date (EU): 2024-05-27. Decision date: 2023-12-05. Results received: No. Last updated: 2026-03-10.

Condition(s): Women with ER+ HER2- metastatic breast cancer who progressed on first line therapy with CDK4/6 inhibitor and aromatase inhibitor
Product: EstroTep 500 MBq/mL, solution injectable

Primary endpoint: Progression-free survival (PFS), defined as the time from randomization to progression or death, among randomized patients
Endpoint(s): Other efficacy endpoints among randomized patients: Progression-free survival (PFS) with available PERCIST tumor evaluation; Overall survival (OS) among randomized patients (arms B and C), Objective response rate (ORR), Clinical benefit rate (CBR) at 24 weeks., Above-mentioned efficacy criteria (PFS, OS, ORR and CBR at 24 weeks) will be evaluated in patients allocated to arm A., Grade 3 or 4 AEs (adverse events) according to NCI CTCAE v5.0, and their relationship to study treatment (chemotherapy or endocrine therapy) will be recorded. For 18F-FES PET/CT, serious adverse events (SAE) and any grade AEs will be collected., QLQ-C30 questionnaire measured at baseline and after 2 months of treatment.

Source: https://euclinicaltrials.eu/ctis-public/view/2023-506282-66-00